EU clinical trial 2024-519005-35-00: A Phase 1/2, Randomized, Double-blind, Placebo-controlled 2-part Study of the Safety, Tolerability, Efficacy, Pharmacokinetics, and Pharmacodynamics of Single Dose ALN-4324 in Overweight to Obese Adult Healthy Volunteers and Multiple Dose ALN-4324 in Overweight to Obese Patients With Type 2 Diabetes Mellitus (T2DM)
Protocol code: ALN-4324-001
Sponsor: Alnylam Pharmaceuticals Inc. (Pharmaceutical company). Phase: Phase I and Phase II (Integrated)- First administration to humans. Countries: Germany (ongoing, recruitment ended), Poland (ongoing, recruitment ended).
Therapeutic area(s): Diseases [C] - Hormonal diseases [C19]
Gender: Female, Male. Age: 18-64 years, 65+ years. Enrolment: 35.
Status: Ongoing, recruitment ended. Start date (EU): 2026-03-09. Decision date: 2026-02-10. Results received: No. Last updated: 2026-08-06.
Decision dates by country: PL: 2026-02-16, DE: 2026-02-10

Condition(s): Type 2 Diabetes Mellitus
Product: Phosphate buffered saline for SC administration

Primary endpoint: Frequency of AEs. Safety will also be evaluated through vital signs, ECGs, and clinical laboratory assessments.
Endpoint(s): Change from baseline in HbA1c at Month 6., Matsuda index, and glucose AUC response to glucose tolerance test. Change from baseline in HOMA-IR, Plasma concentrations of ALN-4324 and potential metabolite(s).

Source: https://euclinicaltrials.eu/ctis-public/view/2024-519005-35-00